EU clinical trial 2023-509453-31-00: A phase I study to evaluate the safety and preliminary signs of efficacy of [177Lu]Lu-OncoFAP-23 alone and in combination with L19-IL2 as a treatment of metastatic FAP-positive solid tumors.
Protocol code: PH-FAPLU-02-23
Sponsor: Philogen S.p.A. (Pharmaceutical company). Phase: Human Pharmacology (Phase I)- First administration to humans. Countries: Italy (ongoing, recruiting).
Therapeutic area(s): Diseases [C] - Neoplasms [C04]
Gender: Female, Male. Age: 18-64 years, 65+ years. Enrolment: 56.
Status: Ongoing, recruiting. Start date (EU): 2025-06-11. Decision date: 2024-09-18. Results received: No. Last updated: 2026-02-10.

Condition(s): Patients with advanced/metastatic FAP-positive tumors

Source: https://euclinicaltrials.eu/ctis-public/view/2023-509453-31-00